EU clinical trial 2023-506990-37-00: Efficacy and safety of Sodium Oxybate in reducing alcohol consumption and maintaining abstinence in alcohol-dependent subjects with high and very high drinking risk level
Protocol code: OXYLIFE
Sponsor: Laboratorio Farmaceutico C.T. S.r.l. (Pharmaceutical company). Phase: Therapeutic confirmatory (Phase III). Countries: Italy (ongoing, recruiting), France (ongoing, recruiting), Poland (ongoing, recruiting).
Therapeutic area(s): Psychiatry and Psychology [F] - Mental Disorders [F03]
Gender: Female, Male. Age: 18-64 years, 65+ years. Enrolment: 240.
Status: Ongoing, recruiting. Start date (EU): 2021-07-13. Decision date: 2023-09-29. Results received: No. Last updated: 2026-07-20.
Decision dates by country: PL: 2024-08-06, FR: 2024-08-21, IT: 2023-09-29

Condition(s): Alcohol addiction
Product: ALCOVER 175 mg/ml soluzione orale, Oral Solution. Each bottle contains 10 ml of solution with the following composition: Sorbitol liquid (70%), Methyl parahydorxybenzoate, Propyl parahydroxybenzoate, Saccharin Sodium, Sour black cherry flavouring, Purified water.

Primary endpoint: The primary end point of the study is the reduction of HDDs as measured by the average number of HDDs after 3 months of treatment (Visit 7, week 12).

Source: https://euclinicaltrials.eu/ctis-public/view/2023-506990-37-00